EU clinical trial 2022-501703-27-00: A Randomized Open-Label Phase 3 Study of XL092 + Nivolumab vs Sunitinib in Subjects with Advanced or Metastatic Non-Clear Cell Renal Cell Carcinoma
Protocol code: XL092-304
Sponsor: Exelixis Inc. (Pharmaceutical company). Phase: Therapeutic confirmatory (Phase III). Countries: Denmark (not authorised), Finland (ongoing, recruitment ended), France (ongoing, recruitment ended), Spain (ongoing, recruitment ended), Netherlands (ongoing, recruitment ended), Poland (ongoing, recruitment ended), Czechia (ongoing, recruitment ended), Hungary (ongoing, recruitment ended), Italy (ongoing, recruitment ended), Germany (ongoing, recruitment ended), Slovakia (ongoing, recruitment ended), Bulgaria (ongoing, recruitment ended), Greece (ongoing, recruitment ended), Croatia (ongoing, recruitment ended).
Therapeutic area(s): Diseases [C] - Neoplasms [C04]
Gender: Female, Male. Age: 18-64 years, 65+ years. Enrolment: 196.
Start date (EU): 2023-07-05. Decision date: 2023-06-20. Results received: No. Last updated: 2026-05-25.
Decision dates by country: DK: 2023-06-21, ES: 2023-06-26, CZ: 2023-06-22, NL: 2023-07-06, IT: 2023-06-29, SK: 2023-09-04, PL: 2023-06-26, HR: 2023-10-09, HU: 2023-06-26, GR: 2023-09-13, BG: 2023-09-25, FR: 2023-06-26, DE: 2023-08-14, FI: 2023-06-21

Condition(s): Advanced or Metastatic Non-Clear Cell Renal Cell Carcinoma
Product: Sunitinib AqVida 25 mg Hartkapseln, XL092, Sunitinib AqVida 12,5 mg Hartkapseln, XL092, XL092, OPDIVO 10 mg/mL concentrate for solution for infusion.

Primary endpoint: Duration of Progression-free survival (PFS) per Response Evaluation Criteria in Solid Tumors version 1.1 (RECIST 1.1), by Blinded Independent Radiology Committee (BIRC), Objective response rate (ORR) as assessed by BIRC per RECIST 1.1
Endpoint(s): Duration of Overall Survival (OS)

Source: https://euclinicaltrials.eu/ctis-public/view/2022-501703-27-00